EU clinical trial 2026-525267-40-00: Intensified Monitoring of PhArmacology of Cabozantinib as a tool for Toxicity management in patients with renal cell carcinoma
Sponsor: Centro Di Riferimento Oncologico Di Aviano (Hospital/Clinic/Other health care facility). Phase: Therapeutic use (Phase IV). Countries: Italy (ongoing, recruiting).
Therapeutic area(s): Diseases [C] - Neoplasms [C04]
Gender: Female, Male. Age: 18-64 years, 65+ years. Enrolment: 216.
Status: Ongoing, recruiting. Start date (EU): 2026-07-30. Decision date: 2026-05-21. Results received: No. Last updated: 2026-05-21.

Condition(s): Renal cell carcinoma
Product: OPDIVO 10 mg/mL concentrate for solution for infusion., Cabozantinib Ipsen 40 mg film-coated tablets, Cabozantinib Ipsen 20 mg film-coated tablets, Cabozantinib Ipsen 60 mg film-coated tablets

Primary endpoint: The impact of the counseling intervention on Cabozantinib related toxicity will be evaluated as the overall reduction of the frequency of treatment interruptions due to clinically relevant toxicity in RCC patients treated with Cabozantinib, compared to historical data.
Endpoint(s): Rate of adherence to pharmacological counseling recommendations., Analytical performance parameters (accuracy, precision, linearity, LLOQ, stability)., Analytical performance parameters (accuracy, precision, linearity, LLOQ, stability). Comparability with LC-MS method., Sensitivity and specificity of Cmin cut-off values for predicting adverse events., Mean/median Cmin difference according to genetic variants., Incidence/severity of treatment-related adverse events according to genetic variants., Mean/median Cmin difference according to inflammatory marker levels., Inflammatory marker levels according to incidence/severity of adverse events., Mean/median values over time., Mean/median difference in ctDNA levels according to disease progression/response., Absolute and relative frequencies., Predictive performance of model-based vs. log-linear extrapolation TDM approaches., Linear regression coefficient with relative 95% CI., Linear regression coefficient with relative 95% CI.

Source: https://euclinicaltrials.eu/ctis-public/view/2026-525267-40-00